EU clinical trial 2022-500785-10-00: A Phase 3, Randomized, Double-blind Trial of Pembrolizumab (MK-3475) Plus Enzalutamide Versus Placebo Plus Enzalutamide in Participants With Metastatic Castration-Resistant Prostate Cancer (mCRPC) (KEYNOTE-641)
Protocol code: MK-3475-641
Sponsor: Merck Sharp & Dohme LLC (Pharmaceutical company). Phase: Therapeutic confirmatory (Phase III). Countries: Austria (ended), Italy (ended), Netherlands (ended), Germany (ended), Hungary (ended), Ireland (ended), Spain (ended), Bulgaria (ended), Czechia (ended), Poland (ended), France (ended).
Therapeutic area(s): Diseases [C] - Neoplasms [C04]
Gender: Male. Age: 18-64 years, 65+ years. Enrolment: 420.
Status: Ended. Start date (EU): 2019-08-23. End date (EU): 2025-08-20. End date: 2026-06-08. Decision date: 2023-01-24. Results received: No. Last updated: 2025-09-10.
Decision dates by country: BG: 2023-03-15, PL: 2023-03-08, NL: 2023-01-24, IT: 2023-02-10, CZ: 2023-03-07, AT: 2023-01-30, FR: 2023-04-12, IE: 2023-02-16, DE: 2023-02-15, HU: 2023-01-26, ES: 2023-03-08

Condition(s): Metastatic Castration-Resistant Prostate Cancer
Product: Normal Saline or Dextrose, ENZALUTAMIDE, KEYTRUDA 25 mg/mL concentrate for solution for infusion

Primary endpoint: Overall Survival (OS), Radiographic Progression-free Survival (rPFS) per Prostate Cancer Working Group (PCWG)-modified Response Evaluation Criteria in Solid Tumors Version 1.1 (RECIST 1.1) as assessed by Blinded Independent Central Review (BICR)
Endpoint(s): Time to Initiation of the First Subsequent Anti-Cancer Therapy or Death (TFST), Prostate-specific Antigen (PSA) Response Rate, Prostate-specific Antigen (PSA) Undetectable Rate, Objective Response Rate (ORR) per Prostate Cancer Working Group (PCWG)-modified Response Evaluation Criteria in Solid Tumors Version 1.1 (RECIST 1.1) as assessed by Blinded Independent Central Review (BICR), Duration of Response (DOR) per Prostate Cancer Working Group (PCWG)-modified Response Evaluation Criteria in Solid Tumors Version 1.1 (RECIST 1.1) as assessed by Blinded Independent Central Review (BICR), Time to Prostate-specific Antigen (PSA) Progression, Time to Radiographic Soft Tissue Progression per Soft Tissue Rules of Prostate Cancer Working Group (PCWG)-modified Response Evaluation Criteria in Solid Tumors Version 1.1 (RECIST 1.1) as assessed by Blinded Independent Central Review (BICR), Time to Pain Progression (TTPP), Time to First Symptomatic Skeletal-Related Event (SSRE), Number of Participants Who Experienced At Least One Adverse Event (AE), Number of Participants Who Discontinued Study Treatment Due to an Adverse Event (AE

Source: https://euclinicaltrials.eu/ctis-public/view/2022-500785-10-00